EU clinical trial 2024-515712-45-00: PERCUTANEOUS EMBOLECTOMY, LOW DOSE THROMBOLYSIS OR HEPARIN FOR INTERMEDIATE HIGH RISK PULMONARY EMBOLISM
Sponsor: Rigshospitalet (Hospital/Clinic/Other health care facility). Phase: Therapeutic use (Phase IV). Countries: Denmark (ongoing, recruiting).
Therapeutic area(s): Diseases [C] - Cardiovascular Diseases [C14]
Gender: Female, Male. Age: 18-64 years, 65+ years. Enrolment: 210.
Status: Ongoing, recruiting. Start date (EU): 2026-07-01. Decision date: 2024-10-18. Results received: No. Last updated: 2026-03-13.

Condition(s): Pulmonary embolism
Product: TINZAPARIN, Actilyse 10 mg powder and solvent for solution for injection and infusion, HEPARIN

Primary endpoint: Reduction in modified Miller score (score of thrombus involvement and segmental flow) comparing percutaneous treated groups (embolectomy and USAT combined) to heparin/LMWH group (n=140 versus n=70), Reduction in modified Miller score (score of thrombus involvement and segmental flow) comparing percutaneous embolectomy and USAT (n=70 versus n=70)
Endpoint(s): Bleeding complications (major and minor bleeding complication according the TIMI classification), Duration of index admission, including hospital-based rehabilitation, Dyspnoea index (Visual analogue scale) after 48-96 h and after 3 months, Rate of further interventions for pulmonary embolism during admission (embolectomy, full dose thrombolysis, mechanical ventilation, need for vasopressors, cardiopulmonary resuscitation, VA-ECMO etc.), Mortality in the three arms (log-rank), and hazard ratio in multivariable analysis using the UFH/LMWH as reference., Incidence of tricuspid regurgitation (TR) gradient > 40 mmHg at 3 months follow-up echocardiography, Six-minute walking distance (6MWD) at 3 months follow-up comparing the three groups, Quality of life (PEmbQoL) at 3 months follow-up comparing the three groups

Source: https://euclinicaltrials.eu/ctis-public/view/2024-515712-45-00